EU clinical trial 2025-521102-17-00: A clinical study of MK-4646 in people with HIV (MK-4646-003)
Protocol code: MK-4646-003
Sponsor: Merck Sharp & Dohme LLC (Pharmaceutical company). Phase: Human Pharmacology (Phase I)- Other. Countries: Romania (ended).
Therapeutic area(s): Diseases [C] - Virus Diseases [C02]
Gender: Female, Male. Age: 18-64 years. Enrolment: 14.
Status: Ended. Start date (EU): 2025-07-31. End date (EU): 2026-06-05. End date: 2026-06-06. Decision date: 2025-07-25. Results received: No. Last updated: 2025-09-02.

Condition(s): HIV infection

Source: https://euclinicaltrials.eu/ctis-public/view/2025-521102-17-00